EU clinical trial 2023-508012-35-00: A Phase 3 Randomized Open-Label Study of Adjuvant Pembrolizumab With or Without MK-2870 in Participants With Resectable Stage II to IIIB (N2) NSCLC not Achieving pCR After Receiving Neoadjuvant Pembrolizumab With Platinum-based Doublet Chemotherapy Followed by Surgery
Protocol code: MK-2870-019
Sponsor: Merck Sharp & Dohme LLC (Pharmaceutical company). Phase: Therapeutic confirmatory (Phase III). Countries: France (ongoing, recruiting), Italy (ongoing, recruiting), Czechia (ongoing, recruiting), Belgium (ongoing, recruiting), Portugal (ongoing, recruiting), Norway (ongoing, recruiting), Spain (ongoing, recruiting), Germany (ongoing, recruiting), Greece (ongoing, recruiting), Netherlands (ongoing, recruiting), Romania (ongoing, recruiting), Poland (ongoing, recruiting), Austria (ongoing, recruiting).
Therapeutic area(s): Diseases [C] - Neoplasms [C04]
Gender: Female, Male. Age: 18-64 years, 65+ years. Enrolment: 258.
Status: Ongoing, recruiting. Start date (EU): 2024-10-02. Decision date: 2024-05-13. Results received: No. Last updated: 2026-07-23.
Decision dates by country: BE: 2024-05-21, FR: 2024-05-17, ES: 2024-05-13, IT: 2024-05-14, RO: 2024-05-20, PT: 2024-05-15, AT: 2024-05-21, CZ: 2024-05-14, NO: 2024-05-14, DE: 2024-05-15, GR: 2024-05-20, NL: 2024-05-21, PL: 2024-05-20

Condition(s): Newly diagnosed NSCLC with resectable clinical Stage II, IIIA or IIIB (with nodal involvement [N2])
Product: GEMCITABINE, CARBOPLATIN, KEYTRUDA 25 mg/mL concentrate for solution for infusion, PEMETREXED, PARACETAMOL, CISPLATIN, PACLITAXEL, MK-2870

Primary endpoint: Disease-free survival (DFS) as assessed by Blinded Independent Central Review (BICR)
Endpoint(s): Overall survival (OS), Distant metastasis-free survival (DMFS) as assessed by investigator, DFS as assessed by investigator, Lung cancer specific survival (LCSS), Number of participants who experience an Adverse Event (AE), Number of participants who discontinue study intervention due to AEs, Change from Baseline in Global health status/Quality of Life (QoL) score (Quality of Life Questionnaire (QLQ)-C30 Items 29 and 30), Change from Baseline in Physical functioning score (QLQ-C30 Items 1 to 5), Change from Baseline in Role functioning score (QLQ-C30 Items 6 and 7), Change from Baseline in Dyspnea scores (QLQ-C30 Item 8), Change from Baseline in Coughing scores (QLQ-LC24 Items 31 and 52), Change from Baseline in Chest pain scores (QLQ-LC24 Item 40)

Source: https://euclinicaltrials.eu/ctis-public/view/2023-508012-35-00